EU clinical trial 2023-503379-33-01: A Phase 3 Randomized, Placebo-controlled, Double-blind Study to Evaluate the Efficacy and Safety of BBP-418 (ribitol) in Patients with Limb Girdle Muscular Dystrophy 2I (LGMD2I)
Protocol code: MLB-01-005
Sponsor: ML Bio Solutions Inc. (Pharmaceutical company). Phase: Therapeutic confirmatory (Phase III). Countries: Denmark (ongoing, recruitment ended), Italy (ongoing, recruitment ended), Netherlands (ongoing, recruitment ended), Norway (ongoing, recruitment ended), Germany (ongoing, recruitment ended).
Therapeutic area(s): Diseases [C] - Musculoskeletal Diseases [C05]
Gender: Female, Male. Age: 18-64 years. Enrolment: 35.
Status: Ongoing, recruitment ended. Start date (EU): 2024-02-12. Decision date: 2024-01-29. Results received: No. Last updated: 2026-07-07.
Decision dates by country: NL: 2024-02-05, DE: 2024-05-31, IT: 2024-01-31, DK: 2024-01-29, NO: 2024-02-15

Condition(s): Limb Girdle Muscular Dystrophy 2I/R9
Product: Placebo to match BBP-418, Ribitol

Primary endpoint: Change from baseline in NSAD at 36 months, Frequency and severity of TEAEs and TESAEs, Results of physical examinations including vital signs, Chemistry and hematology laboratory analyses, 12-lead ECG, including QTc intervals
Endpoint(s): Change from baseline in 10MWT (velocity, m/s) at 36 months, Change from baseline in pulmonary function as measured by FVC (percent predicted, performed in a sitting position) at 36 months, Change from baseline in the PUL2.0 at 36 months, Change from baseline in NSAD at 36 months, Change from baseline in total glycosylated αDG expression, Change from baseline in glycosylated αDG/ total αDG ratio, Change from baseline in pre-functional assessment serum CK

Source: https://euclinicaltrials.eu/ctis-public/view/2023-503379-33-01